EU clinical trial 2026-525554-11-00: Cosmos Trial: Cerebroprotection Of AST-004 in Mild Complicated Traumatic Brain Injuries
Protocol code: AST-004-2-03
Sponsor: Astrocyte Pharmaceuticals Inc. (Pharmaceutical company). Phase: Therapeutic exploratory (Phase II). Countries: Netherlands (authorised, recruitment pending).
Therapeutic area(s): Diseases [C] - Nervous System Diseases [C10]
Gender: Female, Male. Age: 18-64 years, 65+ years. Enrolment: 48.
Status: Authorised, recruitment pending. Decision date: 2026-06-04. Results received: No. Last updated: 2026-06-04.

Condition(s): Traumatic brain injury
Product: AST-004, Identical to test product except without active substance

Primary endpoint: Primary safety endpoint: Safety of different doses of AST-004 as determined by the incidence, frequency, and severity of treatment-emergent adverse events (TEAEs) occurring through Day 7., Primary pharmacodynamic endpoint: Physiologic effect of AST-004 as determined by the change in plasma GFAP from baseline/pre-dose through the dose-completion, 24 hours, Day 7, Day 14 and Day 30 timepoints. The effect at 24 hours will be of primary interest.
Endpoint(s): Clinical effect of AST-004 as determined by change in Rivermead symptom scores from baseline/pre-dose through Day 14., Cerebroprotective effect of AST-004 as determined by differences in neuronal integrity, membrane turnover, glial activation, and neuroinflammation, measured as changes in N-acetylaspartate, choline-containing compounds, and myo-inositol on conventional MR spectroscopy at 24 hours and Day 14, and by the difference between these timepoints

Source: https://euclinicaltrials.eu/ctis-public/view/2026-525554-11-00